EU clinical trial 2024-511625-55-00: AFAMOSI: Prospective, randomized, multicenter Phase IV study to evaluate the efficacy and safety of afatinib followed by osimertinib compared to osimertinib in patients with EGFRmutated/T790M Mutation negative non-squamous NSCLC in the first-line setting
Protocol code: AFAMOSI
Sponsor: Universitaetsmedizin der Johannes Gutenberg-Universitaet Mainz KöR (Hospital/Clinic/Other health care facility). Phase: Therapeutic use (Phase IV). Countries: Germany (ongoing, recruitment ended).
Therapeutic area(s): Diseases [C] - Respiratory Tract Diseases [C08]
Gender: Female, Male. Age: 18-64 years, 65+ years. Enrolment: 126.
Status: Ongoing, recruitment ended. Start date (EU): 2022-11-30. Decision date: 2024-06-21. Results received: No. Last updated: 2026-04-02.

Condition(s): EGFRmutated/T790M Mutation negative non-squamous NSCLC
Product: TAGRISSO 40 mg film-coated tablets, GIOTRIF 40 mg film-coated tablets, GIOTRIF 30 mg film-coated tablets, GIOTRIF 20 mg film-coated tablets, GIOTRIF 30 mg film-coated tablets, GIOTRIF 20 mg film-coated tablets, GIOTRIF 40 mg film-coated tablets, GIOTRIF 40 mg film-coated tablets, GIOTRIF 20 mg film-coated tablets, GIOTRIF 30 mg film-coated tablets, TAGRISSO 80 mg film-coated tablets, TAGRISSO 40 mg film-coated tablets, TAGRISSO 80 mg film-coated tablets

Primary endpoint: Time to EGFR-TKI failure within 24 months for afatinib followed by osimertinib in T790Mpositive group vs osimertinib
Endpoint(s): Time to EGFR-TKI failure (afatinib versus osimertinib), Progression-free survival (PFS: afatinib followed by osimertinib or ICT vs osimertinib followed by ICT), Overall Survival (OS), Response Rate (RR) at 12 months and 24 months, Disease Control Rate (DCR) at 12 months and 24 months, Safety and Tolerability, Symptom control assessed by patient-reported quality of life (QoL) with EQ-5D, EORTC QLQ-C30, EORTC QLQ-LC29

Source: https://euclinicaltrials.eu/ctis-public/view/2024-511625-55-00